EU clinical trial 2026-526036-38-00: Giving Upfront Anti-p40 to Reduce toxicity from Dual Immune Checkpoint Inhibition in MESOthelioma
Sponsor: Erasmus Universitair Medisch Centrum Rotterdam (Erasmus MC) (Hospital/Clinic/Other health care facility). Phase: Therapeutic exploratory (Phase II). Countries: Netherlands (authorised, recruitment pending).
Therapeutic area(s): Diseases [C] - Neoplasms [C04]
Gender: Female, Male. Age: 18-64 years, 65+ years. Enrolment: 42.
Status: Authorised, recruitment pending. Decision date: 2026-07-09. Results received: No. Last updated: 2026-07-09.

Condition(s): Pleural mesothelioma
Product: STELARA 90 mg solution for injection in pre-filled pen, STELARA 130 mg concentrate for solution for infusion

Primary endpoint: The primary endpoint of the study is the incidence of severe (grade ≥3) irAEs occurring within 24 weeks after initiation of dual ICB, graded according to CTCAE version 5.0
Endpoint(s): The incidence of grade ≥2 irAEs within 24 weeks after initiation of dual ICB therapy, graded according to CTCAE version 5.0., Time from initiation of dual ICB to first occurrence of grade ≥3 irAE., Objective response rate on chest CT scan assessed by mRECIST v1.1., Duration of response from initiation of dual ICB until progression or death whichever occurs first., Median progression free survival (PFS) from initiation of dual ICB until progression or death whichever occurs first, The incidence of severe (grade ≥3) irAEs from 24 and 48 weeks after initiation of dual ICB therapy, graded according to CTCAE version 5., T-cell population dynamics after initiation of dual ICB, Serum proteome level dynamics after initiation of dual ICB, cfDNA level dynamics after initiation of dual ICB and at time of irAE occurrence

Source: https://euclinicaltrials.eu/ctis-public/view/2026-526036-38-00